EU clinical trial 2024-513270-21-00: C4951012 - BHV3000-407: A Phase 4, Randomized, Double-blind, Placebo controlled Study to Evaluate the Efficacy and Tolerability of Rimegepant for the Prevention of Migraine in Adults with a History of Inadequate Response to Oral Preventive Medications
Protocol code: C4951012/BHV3000-407
Sponsor: Pfizer Inc. (Pharmaceutical company). Phase: Therapeutic use (Phase IV). Countries: Belgium (ended), Germany (ended), Sweden (ended), Austria (ended), Denmark (ended), Finland (ended), Spain (ended), Poland (ended), Italy (ended).
Therapeutic area(s): Diseases [C] - Nervous System Diseases [C10]
Gender: Female, Male. Age: 18-64 years, 65+ years. Enrolment: 470.
Status: Ended. Start date (EU): 2023-03-14. End date (EU): 2025-07-08. End date: 2025-07-09. Decision date: 2024-08-02. Results received: Yes. Last updated: 2025-04-08.
Decision dates by country: AT: 2024-08-05, FI: 2024-08-05, BE: 2024-08-05, DK: 2024-08-03, PL: 2024-08-04, SE: 2024-08-02, ES: 2024-08-02, IT: 2024-08-14, DE: 2024-08-05

Condition(s): migraine headaches with or without aura
Product: Placebo for Rimegepant 75 mg, VYDURA 75 mg oral lyophilisate

Primary endpoint: Mean change from the Observation Phase in the number of migraine days per month over the entire double-blind treatment (DBT) Phase.
Endpoint(s): Proportion of subjects with ≥ 50% reduction from the Observation Phase in the number of migraine days of moderate or severe headache pain intensity per month over the entire DBT Phase (Weeks 1 to 12)., Mean change from the Observation Phase in the number of migraine days per month in the first 4 weeks (Weeks 1 to 4) of the DBT Phase., Mean change from the Observation Phase in the number of migraine days per month in the last 4 weeks (Weeks 9 to 12) of the DBT Phase., Mean change from baseline in the MSQ restrictive role function domain score at Week 12 of the DBT Phase., Mean change from baseline in the MIBS score at Week 12 of the DBT Phase.

Source: https://euclinicaltrials.eu/ctis-public/view/2024-513270-21-00